EU clinical trial 2023-505140-19-00: A Phase III, International, Multicenter, Randomised Open Label Study to Evaluate the Efficacy and Safety of Obinutuzumab Versus MMF in Patients With Childhood Onset Idiopathic Nephrotic Syndrome
Protocol code: WA43380
Sponsor: F. Hoffmann-La Roche AG (Pharmaceutical company). Phase: Therapeutic confirmatory (Phase III). Countries: Poland (ongoing, recruitment ended), Germany (ended), Belgium (ongoing, recruitment ended), Italy (ongoing, recruitment ended), Spain (ongoing, recruitment ended), France (ongoing, recruitment ended).
Therapeutic area(s): Diseases [C] - Immune System Diseases [C20]
Gender: Female, Male. Age: 0-17 years, 18-64 years. Enrolment: 26.
Start date (EU): 2023-07-31. Decision date: 2024-03-04. Results received: No. Last updated: 2026-06-03.
Decision dates by country: DE: 2024-03-05, ES: 2024-03-04, FR: 2024-03-05, IT: 2024-03-08, BE: 2024-03-27, PL: 2024-03-07

Condition(s): Childhood Idiopathic Nephrotic Syndrome
Product: CellCept 1 g/5 ml powder for oral suspension, Gazyvaro 1,000 mg concentrate for solution for infusion., CellCept 500 mg film-coated tablets, CellCept 500 mg film-coated tablets

Primary endpoint: 1. Percentage of Participants with Sustained Complete Remission at 1 year
Endpoint(s): 1. Overall relapse-free survival (RFS), 2. Probability of RFS at Week 52, 3. Cumulative corticosteroid dose, 4. Number of relapses, 5. Proportion of participants experiencing edema associated relapse during the 52-week treatment period, 6. Proportion of patients with sustained complete remission at Week 76, 7. Mean change in “General Fatigue” domain of PedsQL-Multidimensional Fatigue scale total score from baseline to Week 52, 8. Mean change in “Physical Functioning” domain of PedsQL-Quality of Life Inventory from baseline to Week 52, 9. Mean change in CureGN Edema Scale from baseline to Week 52, 10. Incidence, nature, and severity of adverse events, with severity determined according to AE intensity (mild, moderate, severe, life-threatening) and NCI CTCAE grading if applicable from baseline to Week 52, 11. Incidence of laboratory or vital sign abnormalities from baseline to Week 52, 12. Serum concentrations of obinutuzumab at specified timepoints, 13. Proportion of participants achieving B-cell depletion (HSFC) at specified timepoints, 14. Total peripheral B cell and B cell subsets (e.g., memory B cells) counts and change from baseline at specified timepoints

Source: https://euclinicaltrials.eu/ctis-public/view/2023-505140-19-00